EU clinical trial 2025-520598-38-00: Investigating the pharmacokinetics of petrelintide using different drug product concentrations in participants with a BMI ≥27.0 kg/m2
Protocol code: ZP8396-25041
Sponsor: Zealand Pharma A/S (Pharmaceutical company). Phase: Human Pharmacology (Phase I)- Other. Countries: Germany (ended).
Therapeutic area(s): Diseases [C] - Nutritional and Metabolic Diseases [C18]
Gender: Female, Male. Age: 18-64 years. Enrolment: 48.
Status: Ended. Start date (EU): 2025-12-17. End date (EU): 2026-03-31. Decision date: 2025-11-17. Results received: No. Last updated: 2026-01-22.

Condition(s): Weight reduction

Source: https://euclinicaltrials.eu/ctis-public/view/2025-520598-38-00